EU clinical trial 2025-522582-30-00: A Phase 1, Randomized, Placebo-controlled Study with a Double-blind Period with Open-label Extension Period to Evaluate the Safety, Tolerability, Pharmacokinetics and Pharmacodynamics of Intrathecally Administered ALN-5288 in Adult Patients with Alzheimer’s Disease
Protocol code: ALN-5288-001
Sponsor: Alnylam Pharmaceuticals Inc. (Pharmaceutical company). Phase: Human Pharmacology (Phase I)- First administration to humans. Countries: Spain (ongoing, recruiting), Netherlands (ongoing, recruiting).
Therapeutic area(s): Diseases [C] - Nervous System Diseases [C10]
Gender: Female, Male. Age: 18-64 years, 65+ years. Enrolment: 15.
Status: Ongoing, recruiting. Start date (EU): 2026-04-13. Decision date: 2026-02-10. Results received: No. Last updated: 2026-02-23.
Decision dates by country: ES: 2026-02-12, NL: 2026-02-10

Condition(s): Alzheimer’s Disease

Source: https://euclinicaltrials.eu/ctis-public/view/2025-522582-30-00